EU clinical trial 2022-501686-47-00: A Phase I/II study to evaluate the feasibility, safety and preliminary efficacy of point-of-care manufactured anti-CD19 CAR T in subjects with relapsed or refractory Chronic Lymphocytic Leukemia (CLL) or Small Lymphocytic Lymphoma (SLL)
Sponsor: Galapagos (Pharmaceutical company). Phase: Phase I and Phase II (Integrated)- First administration to humans. Countries: Spain (ended), Belgium (ended), Netherlands (ended).
Therapeutic area(s): Diseases [C] - Neoplasms [C04]
Gender: Female, Male. Age: 18-64 years, 65+ years. Enrolment: 25.
Status: Ended. Start date (EU): 2022-02-28. End date (EU): 2025-08-25. Decision date: 2022-11-04. Results received: Yes. Last updated: 2025-03-21.
Decision dates by country: ES: 2022-11-04, BE: 2023-07-12, NL: 2023-07-20

Condition(s): relapsed/refractory chronic lymphocytic leukemia relapsed/refractory small lymphocytic leukemia
Product: BCN-CP01

Primary endpoint: Phase I: Incidence of (serious) adverse events, including dose-limiting toxicities (DLT), Phase II: Best objective response rate per iwCLL response criteria (Lugano classification for Richter's transformation)

Source: https://euclinicaltrials.eu/ctis-public/view/2022-501686-47-00